EU clinical trial 2024-518272-30-00: RESCUE - Effect of supplemental hydrocortisone during stress in prednisolone-induced adrenal insufficiency; A multicentre, randomised, double blinded, placebo-controlled clinical trial on health-related quality of life in patients with polymyalgia rheumatica/giant cell arteritis receiving ongoing low-dose prednisolone treatment.
Sponsor: Rigshospitalet (Hospital/Clinic/Other health care facility). Phase: Therapeutic use (Phase IV). Countries: Denmark (ongoing, recruitment ended).
Therapeutic area(s): Diseases [C] - Hormonal diseases [C19]
Gender: Female, Male. Age: 18-64 years, 65+ years. Enrolment: 345.
Status: Ongoing, recruitment ended. Start date (EU): 2022-06-01. Decision date: 2025-01-10. Results received: No. Last updated: 2025-09-19.

Condition(s): Glucocorticoid induced adrenal insufficiency
Product: Hydrocortisone Orion 10 mg tabletit, Placebo for hydrocortisone (hydrokortison “orion”) 10 mg tablets for oral administration. placebo is manufactured by glostrup apotek (cvr nr. dk37302872) according to good manufacturing practice for medicinal products.

Primary endpoint: Ecological momentary assessments (EMA) of the Multidimensional Fatigue Inventory (MFI-20), the General Fatigue scale, in situations of stress (Stress EMA). Details: EMA reporting will be done using a study smartphone applica-tion. When patients report stress, the app prompts participants to answer the four momentary MFI-20 General Fatigue questions five time daily at semi ran-domized timepoints for three days. A paper version is available for patients who cannot use a smartphone.
Endpoint(s): Key secondary outcome: EMA version of the MFI-20 General Fatigue scale at baseline (baseline EMA) and at fixed timepoints monthly (unstressed EMA), Key secondary outcome: SF-36v2 questionnaire, Key secondary outcome: Daily ‘end-of-day’ smartphone app facilitated patient reported symptoms of adrenal insufficiency and intercurrent illness and stress. The questions about symptoms originate from the Danish version of the PRO-CTCAE questionnaire., Key secondary outcome: AddiQol-30 questionnaire, Key secondary outcome: PMR/GCA treatment characteristics: Duration of prednisolone tapering from 5 mg to complete withdrawal; Accumulated dose of glucocorticoid treatment; Duration of prednisolone treatment for PMR/GCA., Key secondary outcome: Number of ‘sick days’, Key secondary outcome: ACTH test results depending on the length of the prednisolon pause: ACTH test results (basal and stimulated plasma cortisol) after 0, 1, or 2 days prednisolone pause; Prednisolone cross reactivity in Roche Elecsys cortisol II immunoassay in plasma 2 hours, 4 hours, 1 day and 2 days after last prednisolone intake; ACTH concentrations (central HPA axis recovery)., Safety outcomes: Adrenal insufficiency: Incidence rate and grade of adrenal crises; Number of hospitalisations, Safety outcome: Exogenous Cushing’s Syndrome - Body composition and muscle strength: Dual-energy X-ray absorptiometry (DXA) scan (fat percentage, body composition, bone mineral density); Waist- and hip circumference, weight, height, body mass index (BMI); Timed up and go; Handgrip strength; Short Physical Performance Battery and chair rising test., Safety outcome: Exogenous Cushing’s Syndrome - Bone quality: Bone markers in blood and urine, Safety outcome: Exogenous Cushing’s Syndrome - Metabolic and cardiovascular risk: Automated office blood pressure; Coagulation and Inflammation markers in blood; Metabolic and cardiovascular markers in blood and urine., Safety outcome: Exogenous Cushing’s Syndrome - Patient reported symptoms: CushingQol questionnaire; Single item Sleep Quality Scale (SQS) questionnaire, Exploratory outcome: PMR/GCA treatment characteristics: Number of PMR/GCA disease flare up/relapse, and disease activity of the PMR/GCA., Exploratory outcome: Biological integrated cortisol status assessment: ACTH test for normalization of adrenal function; 24h urine; Salivary cortisol and cortisone during ACTH tests (determined by Roche immunoassay and LC-MS); Cortisol binding globulin (CBG) in plasma to calculate Free Cortisol Index (total P-cortisol concentration (nmol/l)/serum CBG (in mg/L). Circulating biomarkers of glucocorticoid effects and adverse effects (incl. glucocorticoid receptor gene polymorphisms).

Source: https://euclinicaltrials.eu/ctis-public/view/2024-518272-30-00